EU clinical trial 2023-509268-26-00: EVOLVE-MI: A Pragmatic Randomized Multicenter Trial of EVOLocumab Administered Very Early to Reduce the Risk of Cardiovascular Events in Patients Hospitalized With Acute Myocardial Infarction
Protocol code: 20190184
Sponsor: Amgen Inc. (Pharmaceutical company). Phase: Therapeutic use (Phase IV). Countries: Sweden (ongoing, recruitment ended).
Therapeutic area(s): Diseases [C] - Nutritional and Metabolic Diseases [C18]
Gender: Female, Male. Age: 18-64 years, 65+ years. Enrolment: 700.
Status: Ongoing, recruitment ended. Start date (EU): 2024-01-08. Decision date: 2024-04-04. Results received: No. Last updated: 2026-03-26.

Condition(s): Dyslipidemia
Product: EVOLOCUMAB

Primary endpoint: Total (first and subsequent) composite of myocardial infarction, ischemic stroke, any arterial revascularization procedure, and all-cause death.
Endpoint(s): Percent LDL-C change from baseline to 12 weeks and 52 week in a subset of approximately 300 selected subjects., Total (first and subsequent) composite of myocardial infarction, ischemic stroke, any arterial revascularization procedure, and cardiovascular death., Time to the first occurrence of the composite of myocardial infarction, ischemic stroke, revascularization procedure, and all-cause death., Total myocardial infarctions, Total arterial revascularization procedures, Total ischemia-driven coronary revascularization procedures, Total ischemic strokes, Cardiovascular death, All-cause death

Source: https://euclinicaltrials.eu/ctis-public/view/2023-509268-26-00